EU clinical trial 2023-507817-85-00: A Phase III, Multicenter, Open-Label, Uncontrolled Study to Evaluate Pharmacokinetics, Efficacy, Safety, Tolerability, and Pharmacodynamics of Satralizumab in Pediatric Patients with AQP4 Antibody Positive Neuromyelitis Optica Spectrum Disorder (NMOSD)
Protocol code: WN41733
Sponsor: F. Hoffmann-La Roche AG (Pharmaceutical company). Phase: Therapeutic confirmatory (Phase III). Countries: Italy (authorised, recruiting), France (authorised, recruiting), Poland (ongoing, recruiting).
Therapeutic area(s): Diseases [C] - Nervous System Diseases [C10]
Gender: Female, Male. Age: 0-17 years. Enrolment: 7.
Start date (EU): 2022-04-21. Decision date: 2024-07-16. Results received: No. Last updated: 2026-08-05.
Decision dates by country: IT: 2024-08-13, PL: 2024-07-22, FR: 2024-07-16

Condition(s): Neuromyelitis Optica Spectrum Disorder (NMOSD)
Product: Satralizumab, Satralizumab

Primary endpoint: 1. Summary of observed serum concentration of satralizumab at specified trough timepoints (mean and standard deviation of trough concentration [Ctrough] at each sampling timepoint), 2. Population and individual estimates of PK parameters using a population-PK modeling approach
Endpoint(s): 1. Proportion of relapse-free participants by Week 48, 2. Annualized relapse rate (ARR), 3. Time to first relapse (TFR), 4. Time to relapse requiring rescue therapy, 5. Change from baseline in Expanded Disability Status Scale (EDSS) at Weeks 24 and 48, 6. Change from baseline in visual acuity (evaluated using standardized logMAR visual acuity charts, such as Sloan charts, LEA Symbols® chart, and HOTV chart) at Weeks 24 and 48, 7. Change from baseline in FACES® Pain Rating Scale at Weeks 24 and 48, 8. Change from baseline in EuroQol 5-Dimension, Youth (EQ-5D-Y) score and its proxy (for participants younger than 8 years of age) at Weeks 24 and 48, 9. Incidence and severity of adverse events, adverse events of special interest, serious adverse events, 10. Change from baseline in targeted vital signs, 11. Change from baseline in weight and height, 12. Change from baseline in targeted clinical laboratory test results, 13. Change from baseline in targeted ECG parameters, 14. Incidence of anti-drug antibodies (ADAs) at baseline and incidence of ADAs during the study

Source: https://euclinicaltrials.eu/ctis-public/view/2023-507817-85-00